EU clinical trial 2024-514704-13-00: A Phase 1a/1b Study to Investigate the Safety, Tolerability, Pharmacokinetics, Pharmacodynamics, and Preliminary Antitumor Activity of BGB-53038, a Pan-KRAS Inhibitor, as Monotherapy or in Combinations in Patients With Advanced or Metastatic Solid Tumors With KRAS Mutations or Amplification
Protocol code: BGB-53038-101
Sponsor: BeOne Medicines AG (Pharmaceutical company). Phase: Human Pharmacology (Phase I)- First administration to humans. Countries: Spain (ended).
Therapeutic area(s): Diseases [C] - Neoplasms [C04]
Gender: Female, Male. Age: 18-64 years, 65+ years. Enrolment: 30.
Status: Ended. End date (EU): 2026-04-23. Decision date: 2025-04-11. Results received: No. Last updated: 2026-04-30.

Condition(s): Advanced or Metastatic Solid Tumors with KRAS Mutations or Amplifications

Source: https://euclinicaltrials.eu/ctis-public/view/2024-514704-13-00